EU clinical trial 2024-516939-28-00: A randomized phase II trial of docetaxel or cabazitaxel with or without darolutamide in men with metastatic castration-resistant prostate cancer.
Protocol code: DAROTAXEL
Sponsor: Erasmus Universitair Medisch Centrum Rotterdam (Erasmus MC) (Hospital/Clinic/Other health care facility). Phase: Therapeutic exploratory (Phase II). Countries: Netherlands (ongoing, recruiting).
Therapeutic area(s): Diseases [C] - Male Urogenital Diseases [C12]
Gender: Male. Age: 18-64 years, 65+ years. Enrolment: 245.
Status: Ongoing, recruiting. Start date (EU): 2024-10-28. Decision date: 2024-10-28. Results received: No. Last updated: 2026-03-10.

Condition(s): metastatic castration-resistant prostate cancer
Product: NUBEQA 300 mg film-coated tablets, TAXOTERE 20 mg/0.5 ml concentrate and solvent for solution for infusion, JEVTANA 60 mg concentrate and solvent for solution for infusion.

Primary endpoint: The main study endpoint is progression free survival, which is defined as time from randomization to radiologic, biochemical or pain progression or death from any cause, whichever occurs first, according to PCWG3 (Appendix C).
Endpoint(s): Overall survival, defined as time from randomization to death from any cause., Time to progression, defined as time from randomization to radiologic, biochemical or pain progression, whichever occurs first., The time to PSA progression, defined as time from randomization to biochemical progression., The time to pain progression, defined as time from randomization to pain progression., The number and severity of adverse events, Cell-free DNA aneuploidy scores and somatic aberrations in circulating tumor DNA, Differential expression of relevant genes, as measured in tissue and liquid biopsies. (comparing tissue and liquid biopsies at baseline and on-treatmen, Immune subset phenotyping and subtyping as measured in tissue and whole blood

Source: https://euclinicaltrials.eu/ctis-public/view/2024-516939-28-00